EU clinical trial 2024-510575-38-00: Glo-BNHL: A Global Study of Novel Agents in Paediatric and Adolescent Relapsed and Refractory B-cell Non-Hodgkin Lymphoma
Protocol code: RG_21-124
Sponsor: The University Of Birmingham (Educational Institution). Phase: Phase II and Phase III (Integrated). Countries: Austria (ongoing, recruiting), Belgium (authorised, recruitment pending), Netherlands (authorised, recruitment pending), Sweden (authorised, recruitment pending), France (authorised, recruitment pending), Spain (authorised, recruitment pending).
Therapeutic area(s): Diseases [C] - Neoplasms [C04]
Gender: Female, Male. Age: 0-17 years, 18-64 years. Enrolment: 37.
Start date (EU): 2026-02-24. Decision date: 2025-08-11. Results received: No. Last updated: 2026-08-03.
Decision dates by country: AT: 2025-08-11, BE: 2025-08-11, SE: 2025-08-11, NL: 2025-08-12, FR: 2026-02-16, ES: 2026-02-16

Condition(s): Relapsed and refractory mature B-cell non-Hodgkin Lymphoma
Product: Odronextamab, IFOSFAMIDE, ETOPOSIDE PHOSPHATE, CARBOPLATIN, ETOPOSIDE, DEXAMETHASONE, Zynlonta 10 mg powder for concentrate for solution for infusion, Odronextamab, DEXAMETHASONE, DEXAMETHASONE, IFOSFAMIDE, RITUXIMAB, DEXAMETHASONE, DEXAMETHASONE

Primary endpoint: Treatment Arm I: BsAb: Occurrence of an objective response (OR) i.e. Complete Response (CR) or Partial Response (PR) after 12 weeks of treatment assessed by Independent Central Review (according to International Paediatric Non-Hodgkin Lymphoma Response Criteria), Treatment Arm II: ADC with standard chemotherapy: Occurrence of CR within a maximum of three cycles of treatment assessed by Independent Central Review (according to International Paediatric Non-Hodgkin Lymphoma Response Criteria)
Endpoint(s): Event-free survival time (EFS), Progression-free survival time (PFS), Overall survival time (OS), Best overall response (BOR) during treatment, Duration of response (DOR), Occurrence of an objective response (OR), where relevant, Occurrence of adverse events of special interest (AESI), Occurrence of treatment emergent adverse events (TEAEs), where relevant, Pharmacokinetic profile of novel agent, where relevant, Pharmacodynamic markers, where relevant

Source: https://euclinicaltrials.eu/ctis-public/view/2024-510575-38-00